EU clinical trial 2024-517238-16-00: A Phase 3, Open-Label, Long-Term Extension Study to Evaluate the Safety and Efficacy of Vosoritide in Children with Hypochondroplasia
Protocol code: 111-308
Sponsor: Biomarin Pharmaceutical Inc. (Pharmaceutical company). Phase: Therapeutic confirmatory (Phase III). Countries: France (ongoing, recruiting), Spain (ongoing, recruiting), Italy (ongoing, recruiting), Germany (ongoing, recruiting).
Therapeutic area(s): Diseases [C] - Congenital, Hereditary, and Neonatal Diseases and Abnormalities [C16]
Gender: Female, Male. Age: 0-17 years. Enrolment: 44.
Status: Ongoing, recruiting. Start date (EU): 2026-01-28. Decision date: 2025-11-03. Results received: No. Last updated: 2026-07-03.
Decision dates by country: FR: 2025-11-13, DE: 2025-11-03, ES: 2025-11-12, IT: 2025-11-11

Condition(s): Hypochondroplasia
Product: Voxzogo 1.2 mg powder and solvent for solution for injection, Voxzogo 0.4 mg powder and solvent for solution for injection, Voxzogo 0.56 mg powder and solvent for solution for injection

Primary endpoint: 1. Incidence of treatment emergent adverse events over time until FAH, 2. Change from baseline in height Z-score yearly until FAH, 3. Change from baseline in height yearly until FAH
Endpoint(s): 1. Change from baseline in height at Week 52 of Study 111-308, 2. Change from baseline in height Z-score at Week 52 of Study 111-308 Baseline is based on first dose of study drug (vosoritide or placebo) in the parent study (111-303 or 111 212).

Source: https://euclinicaltrials.eu/ctis-public/view/2024-517238-16-00